EU clinical trial 2025-522176-86-01: A Phase 2b/3, Randomized, Double-Blinded, Placebo Controlled Study ChecKing the Efficacy and Safety of ATAciguat to Slow the Progression of VaLvular DYsfunction in Participants with Moderate Calcific Aortic Valve STenosis (KATALYST-AV)
Protocol code: ATA-301
Sponsor: Kardigan Inc. (Pharmaceutical company). Phase: Therapeutic confirmatory (Phase III). Countries: Norway (authorised, recruitment pending), Czechia (authorised, recruitment pending), Portugal (authorised, recruitment pending), Austria (authorised, recruitment pending), Poland (authorised, recruitment pending), France (authorised, recruitment pending), Spain (authorised, recruitment pending).
Therapeutic area(s): Diseases [C] - Cardiovascular Diseases [C14]
Gender: Female, Male. Age: 18-64 years, 65+ years. Enrolment: 496.
Status: Authorised, recruitment pending. Decision date: 2026-06-08. Results received: No. Last updated: 2026-06-12.
Decision dates by country: ES: 2026-06-12, AT: 2026-06-08, PT: 2026-06-09, NO: 2026-06-12, PL: 2026-06-12, FR: 2026-06-10, CZ: 2026-06-09

Condition(s): Moderate Calcific Aortic Valve Stenosis (CAVS)
Product: Ataciguat, Placebo to match IMP/ataciguat

Primary endpoint: 1. (Part B) Percent change in AVA as measured by echocardiogram from baseline to Week 48, 2. (Part B) Change in peak VO2 as assessed by CPET from baseline to Week 48
Endpoint(s): 1. (Part B) Change in AVC score as assessed by non-contrast CT from baseline to Week 48., 2. (Part B) Time to decision to proceed with TAVR/SAVR or all-cause death; Percentage of participants with AS progression to AVA <1.0cm2 at Week 48

Source: https://euclinicaltrials.eu/ctis-public/view/2025-522176-86-01